EU clinical trial 2024-516421-30-00: Neonatal hypoxic ischemic encephalopathy : safety and feasibility study of a curative treatment with autologous cord blood stem cells (NEOSTEM)
Sponsor: Centre Hospitalier Regional De Marseille (Hospital/Clinic/Other health care facility). Phase: Therapeutic exploratory (Phase II). Countries: France (ongoing, recruiting).
Therapeutic area(s): Diseases [C] - Congenital, Hereditary, and Neonatal Diseases and Abnormalities [C16]
Gender: Female, Male. Age: 0-17 years. Enrolment: 20.
Status: Ongoing, recruiting. Start date (EU): 2020-02-05. Decision date: 2024-09-10. Results received: No. Last updated: 2024-09-10.

Condition(s): Neonatal hypoxic-ischaemic encephalopathy
Product: Autologous cord blood-derived viable nuclear cells 50E6/kg prep

Primary endpoint: Occurrence of clinical or paraclinical adverse events during the child's follow-up (short- and long-term), attributable to the injected cell preparation, Feasibility of the study: percentage of children included for whom the cell therapy procedure could be completed according to the required quality criteria.
Endpoint(s): - Preliminary efficacy as measured by neurodevelopmental function till 2 years

Source: https://euclinicaltrials.eu/ctis-public/view/2024-516421-30-00